EU clinical trial 2024-510875-39-00: A Phase 3 Multi-Center Study to Evaluate the Safety and Efficacy of Subcutaneous Injections of Pegvaliase in Adolescent Subjects (Ages 12-17) with Phenylketonuria Featuring an Open-Label Randomized Two-Arm (Active vs Diet-Only Control) Design
Protocol code: 165-306
Sponsor: Biomarin Pharmaceutical Inc. (Pharmaceutical company). Phase: Therapeutic confirmatory (Phase III). Countries: Germany (ongoing, recruitment ended).
Therapeutic area(s): Diseases [C] - Nutritional and Metabolic Diseases [C18]
Gender: Female, Male. Age: 0-17 years. Enrolment: 11.
Status: Ongoing, recruitment ended. Start date (EU): 2022-10-25. Decision date: 2024-07-04. Results received: No. Last updated: 2026-05-19.

Condition(s): Phenylketonuria (PKU)
Product: Palynziq 2.5 mg solution for injection in pre-filled syringe, Palynziq 20 mg solution for injection in pre-filled syringe, Palynziq 10 mg solution for injection in pre-filled syringe

Primary endpoint: Safety will be evaluated by assessment of AEs, SAEs, laboratory test results (chemistry, hematology, and urinalysis), vital signs physical examination, ECG and anti-BMN165 immunogenicity test results
Endpoint(s): Change from baseline in total dietary protein intake (ie, medical food and/or intact food)., Plasma sample for trough PK

Source: https://euclinicaltrials.eu/ctis-public/view/2024-510875-39-00